EU clinical trial 2024-517584-23-00: A 2-Part, Randomized, Double-Blind, Placebo-Controlled Study in Participants with Duchenne Muscular Dystrophy Amenable to Exon 44 Skipping with an Initial Multiple Ascending Dose Part A to Assess the Safety, Tolerability, Pharmacokinetics and Pharmacodynamics of ENTR-601-44, Followed by Part B to Evaluate the Safety and Efficacy of ENTR-601-44 (ELEVATE-44)
Protocol code: ENTR-601-44-201
Sponsor: Entrada Therapeutics Inc. (Pharmaceutical company). Phase: Phase I and Phase II (Integrated)- Other. Countries: Spain (ongoing, recruiting), Belgium (ongoing, recruiting), Italy (ongoing, recruiting).
Therapeutic area(s): Diseases [C] - Musculoskeletal Diseases [C05]
Gender: Female, Male. Age: 0-17 years, 18-64 years. Enrolment: 9.
Status: Ongoing, recruiting. Start date (EU): 2025-05-16. Decision date: 2025-04-30. Results received: No. Last updated: 2026-04-08.
Decision dates by country: BE: 2025-04-30, ES: 2025-04-30, IT: 2025-05-05

Condition(s): Duchenne Muscular Dystrophy
Product: ENTR-601-44, SODIUM CHLORIDE

Primary endpoint: Incidence and severity of treatment emergent adverse events (TEAEs) (Part A and OL Period)), Changes in vital sign measurements (Part A and OL Period), Changes in clinical laboratory results (Part A and OL Period), Changes in electrocardiogram (ECG) parameters (Part A and OL Period), Changes in physical examination findings (Part A and OL Period)
Endpoint(s): Plasma, muscle, and urine concentration of ENTR-601-44 and its final metabolite (Part A and OL Period), Change from baseline in dystrophin by Western blot from muscle biopsy (Part A), Change from baseline to End of Part A in dystrophin expression and localization from muscle biopsy (Part A), Percent change from baseline to End of Part A in exon 44 skipping measured in muscle biopsy (Part A), Anti-drug antibody (ADA) and anti-dystrophin antibody in serum (Part A and OL Period)), Change from baseline to End of OL Period in 10-Meter Walk/Run (10MWR) (Part A and OL Period), Change from baseline to End of OL Period in Timed Rise from Floor (Part A and OL Period), Change from baseline to End of OL Period in Timed 4-Stair Climb (4SC) (Part A and OL Period), Change from baseline to End of OL Period in 95th centile Stride Velocity (SV95C) (Part A and OL Period), Change from baseline to End of OL Period in North Star Ambulatory Assessment (NSAA) (Part A and OL Period), Change from baseline to End of OL Period in Performance of the Upper Limb v2.0 (PUL 2.0) (Part A and OL Period)

Source: https://euclinicaltrials.eu/ctis-public/view/2024-517584-23-00